EU clinical trial 2023-508804-39-00: A Phase 3b Extension Study to Evaluate the Long-Term Safety of Vedolizumab Subcutaneous in Pediatric Subjects With Ulcerative Colitis or Crohn’s Disease
Protocol code: VedolizumabSC-3004
Sponsor: Takeda Development Center Americas Inc. (Pharmaceutical company). Phase: Therapeutic confirmatory (Phase III). Countries: Spain (authorised, recruitment pending), Ireland (authorised, recruitment pending), Portugal (authorised, recruitment pending), Poland (ongoing, recruiting), Belgium (authorised, recruitment pending), Netherlands (authorised, recruitment pending), Bulgaria (authorised, recruitment pending), Romania (ongoing, recruiting), Italy (authorised, recruitment pending), Denmark (authorised, recruitment pending).
Therapeutic area(s): Diseases [C] - Digestive System Diseases [C06]
Gender: Female, Male. Age: 0-17 years. Enrolment: 32.
Start date (EU): 2025-10-15. Decision date: 2025-09-29. Results received: No. Last updated: 2026-05-08.
Decision dates by country: BG: 2025-10-06, DK: 2025-09-29, IE: 2025-10-03, RO: 2025-10-02, ES: 2025-10-06, PL: 2025-10-06, NL: 2025-10-06, PT: 2025-09-29, BE: 2025-10-06, IT: 2025-09-30

Condition(s): Ulcerative Colitis or Crohn’s Disease
Product: Entyvio 108 mg solution for injection in pre-filled syringe, Entyvio 108 mg solution for injection in pre-filled pen

Primary endpoint: Observational Cohort: Incidence of safety events (SAEs, serious infections, malignancies, PML, bowel surgery, and delay in growth or pubertal development)., Treatment Cohort: The primary endpoints for this study are the incidence of adverse events (AEs), serious adverse events (SAEs), and adverse events of special interest (AESIs) (ie, infections including opportunistic infection, such as PML; liver injury; malignancies; injection-related reactions or systemic reactions including anaphylaxis and hypersensitivity reactions)
Endpoint(s): Treatment Cohort: Time to major IBD-related events (eg, hospitalizations, surgeries, or procedures) from Day 1 of Study VedolizumabSC-3004., Changes from baseline of Study VedolizumabSC-3003 in IMPACT-III total and subscale scores for subjects aged 9 to 17 years

Source: https://euclinicaltrials.eu/ctis-public/view/2023-508804-39-00